EU clinical trial 2024-518998-33-00: A Phase 3b, Multicenter, Randomized, Open-Label Study of Risankizumab Compared to Vedolizumab for the Treatment of Adult Subjects With Moderate to Severe Ulcerative Colitis Who are Naïve to Targeted Therapies
Protocol code: M25-540
Sponsor: AbbVie Deutschland GmbH & Co. KG (Pharmaceutical company). Phase: Therapeutic confirmatory (Phase III). Countries: Estonia (ongoing, recruitment ended), Spain (ongoing, recruitment ended), Latvia (ongoing, recruitment ended), Lithuania (ongoing, recruitment ended), Germany (ongoing, recruitment ended), Ireland (ongoing, recruitment ended), Croatia (ongoing, recruitment ended), Slovenia (ongoing, recruitment ended), Sweden (ongoing, recruitment ended), Austria (ongoing, recruitment ended), Italy (ongoing, recruitment ended), Finland (ongoing, recruitment ended), Netherlands (ongoing, recruitment ended), Bulgaria (ongoing, recruitment ended), Hungary (ongoing, recruitment ended), Poland (ongoing, recruitment ended), Czechia (ongoing, recruitment ended), France (ongoing, recruitment ended), Romania (ongoing, recruitment ended), Slovakia (ongoing, recruitment ended).
Therapeutic area(s): Diseases [C] - Digestive System Diseases [C06]
Gender: Female, Male. Age: 18-64 years, 65+ years. Enrolment: 293.
Status: Ongoing, recruitment ended. Start date (EU): 2025-07-23. Decision date: 2025-07-15. Results received: No. Last updated: 2026-05-06.
Decision dates by country: SK: 2025-10-01, ES: 2025-07-16, AT: 2025-07-21, FR: 2025-11-03, NL: 2025-07-15, IE: 2025-07-18, LV: 2025-07-16, CZ: 2025-11-03, IT: 2025-07-17, SE: 2025-07-15, BG: 2025-07-21, HU: 2025-07-18, DE: 2025-07-29, PL: 2025-07-18, EE: 2025-07-16, HR: 2025-07-21, LT: 2025-07-17, RO: 2025-11-12, FI: 2025-07-15, SI: 2025-07-15

Condition(s): Ulcerative Colitis
Product: ABBV-066 / Risankizumab, ABBV-066, Entyvio 300 mg powder for concentrate for solution for infusion

Primary endpoint: Achievement of endoscopic improvement at Week 48, defined as a centrally read endoscopy subscore of 0 or 1 (score of 1 modified to exclude friability): superiority of risankizumab vs. vedolizumab.
Endpoint(s): The achievement of clinical remission per mMS at Week 48, defined as SFS ≤ 1 and not greater than Baseline, RBS = 0, and a centrally read endoscopy subscore of 0 or 1 (score of 1 modified to exclude friability): non-inferiority of risankizumab vs. vedolizumab test first followed by superiority test.

Source: https://euclinicaltrials.eu/ctis-public/view/2024-518998-33-00